EU clinical trial 2025-523811-12-00: A Multicenter, Randomized, Operationally Seamless Phase 2/3 Study to Evaluate the Efficacy and Safety of BMN 333 versus Vosoritide in Children with Achondroplasia
Protocol code: 333-301
Sponsor: Biomarin Pharmaceutical Inc. (Pharmaceutical company). Phase: Phase II and Phase III (Integrated). Countries: Poland (authorised, recruitment pending), Italy (authorised, recruitment pending), Romania (authorised, recruitment pending).
Therapeutic area(s): Diseases [C] - Congenital, Hereditary, and Neonatal Diseases and Abnormalities [C16]
Gender: Female, Male. Age: 0-17 years. Enrolment: 25.
Status: Authorised, recruitment pending. Decision date: 2026-05-05. Results received: No. Last updated: 2026-05-05.
Decision dates by country: IT: 2026-05-05, RO: 2026-05-05, PL: 2026-05-05

Condition(s): Achondroplasia
Product: BMN 333, Voxzogo 0.56 mg powder and solvent for solution for injection, Voxzogo 1.2 mg powder and solvent for solution for injection, BMN 333

Primary endpoint: Phase 2: Predicted AGV at Week 52 (based on AGV at Weeks 26, 39, and 52 [available cumulative data]), Phase 3: AGV at Week 52
Endpoint(s): Phase 2: 1.AGV at Weeks 26 and 52 2.Change from Baseline in standing height, height Z-score and in upper to lower body segment ratio at Weeks 26 and 52 3.Incidence of AEs, SAEs, and EOIsa; physical examinations; vital signs; ECG findings; imaging results (X-ray and DXA); clinical laboratory tests., Phase 3: • Change from Baseline in standing height, height Z-score, upper to lower body segment ratio at Week 52

Source: https://euclinicaltrials.eu/ctis-public/view/2025-523811-12-00